EU clinical trial 2023-508433-14-00: A Phase 3, Randomized, Double-Blind, Placebo-Controlled Study to Evaluate the Efficacy, Safety, and Tolerability of Valbenazine as Adjunctive Treatment in Subjects with Schizophrenia
Protocol code: NBI-98854-ATS3019
Sponsor: Neurocrine Biosciences Inc. (Pharmaceutical company). Phase: Therapeutic confirmatory (Phase III). Countries: Bulgaria (ended), Croatia (ended), Czechia (ended), Romania (ended), Spain (ended), Slovakia (ended).
Therapeutic area(s): Psychiatry and Psychology [F] - Behavioral Disciplines and Activities [F04]
Gender: Female, Male. Age: 18-64 years, 65+ years. Enrolment: 192.
Status: Ended. Start date (EU): 2022-09-30. End date (EU): 2025-02-11. End date: 2025-02-18. Decision date: 2024-03-07. Results received: Yes. Last updated: 2024-10-14.
Decision dates by country: BG: 2024-03-07, HR: 2024-10-14, CZ: 2024-10-14, RO: 2024-10-14, ES: 2024-09-05, SK: 2024-09-24

Condition(s): Schizophrenia
Product: Valbenazine, Valbenazine, Placebo for valbenazine capsules

Primary endpoint: Change in PANSS total score from baseline to Week 10.
Endpoint(s): Change in CGI-S score from baseline to Week 10, Change in Personal and Social Performance Scale (PSP) score from baseline to Week 10

Source: https://euclinicaltrials.eu/ctis-public/view/2023-508433-14-00